EU clinical trial 2022-502858-14-00: A Long-term Safety Extension Study of Mavacamten (MYK-461) in Adults with Hypertrophic Cardiomyopathy Who Have Completed the MAVERICKHCM (MYK-461-006) or EXPLORER-HCM (MYK-461-005) Trials (MAVA-LTE)
Protocol code: MYK 461-007
Sponsor: Myokardia Inc. (Pharmaceutical company). Phase: Therapeutic confirmatory (Phase III). Countries: Spain (ended), Netherlands (ended), Denmark (ended), France (ended), Belgium (ended), Czechia (ended), Germany (ended), Portugal (ended), Italy (ended), Poland (ended).
Therapeutic area(s): Diseases [C] - Cardiovascular Diseases [C14]
Gender: Female, Male. Age: 18-64 years, 65+ years. Enrolment: 190.
Status: Ended. Start date (EU): 2019-09-05. End date (EU): 2026-01-16. End date: 2026-01-17. Decision date: 2023-10-04. Results received: No. Last updated: 2025-09-27.
Decision dates by country: DK: 2023-10-05, FR: 2023-10-05, PT: 2023-10-11, BE: 2023-10-05, IT: 2023-10-06, NL: 2023-10-04, ES: 2023-10-05, CZ: 2023-10-10, DE: 2023-10-06, PL: 2023-11-10

Condition(s): Hypertrophic cardiomyopathy
Product: Mavacamten, Mavacamten, Mavacamten, Mavacamten

Primary endpoint: Incidence of major adverse cardiac events (death, stroke, acute myocardial infarction), Incidence of hospitalizations (both cardiovascular [CV] and non-CV), Incidence of heart failure (HF) events (includes HF hospitalizations and urgent emergency room/outpatient visits for HF), Incidence of atrial fibrillation/flutter (new from Screening Visit), Incidence of ICD discharges and resuscitated cardiac arrest, Incidence of ventricular tachyarrhythmias (includes ventricular tachycardia or ventricular fibrillation), Incidence of any AE potentially linked to QT prolongation (Torsade de pointes, CV or sudden death, sustained ventricular tachycardia, ventricular fibrillation and flutter, syncope, and seizures), Frequency and severity of treatment-emergent AEs, treatment-emergent serious AEs, and laboratory abnormalities (including trends in NT-proBNP), For Participants from EXPLORER-HCM Change from Week 24 in left ventricular (LV) mass index For Participants from MAVERICK-HCM Change from baseline in LV mass index
Endpoint(s): Change from baseline in ECHO parameters of systolic function (eg, LVEF) and diastolic function (eg, peak velocity of early diastolic septal and lateral mitral annular motion [eꞌ], ratio of peak velocity of early diastolic transmitral flow [E] to eꞌ [E/eꞌ], ratio of E to peak velocity of late transmitral flow [A] [E/A], pulmonary artery systolic pressure, or left atrium size) over time., Change from baseline in resting and post-Valsalva LVOT gradient (EXPLORER-HCM participants only), Change from baseline in New York Heart Association functional class over time, Change from baseline in NT-proBNP over time, Frequency of cardiac transplantation

Source: https://euclinicaltrials.eu/ctis-public/view/2022-502858-14-00